EU clinical trial 2024-511362-37-00: A Phase III, Open-label, Sponsor-blind, Randomized Study of Dato-DXd With or Without Osimertinib Versus Platinum-based Doublet Chemotherapy for Participants with EGFR-mutated Locally Advanced or Metastatic Non-small Cell Lung Cancer whose Disease has Progressed on Prior Osimertinib Treatment (TROPION-Lung15)
Protocol code: D516KC00001
Sponsor: AstraZeneca AB (Pharmaceutical company). Phase: Therapeutic confirmatory (Phase III). Countries: France (ongoing, recruitment ended), Poland (ongoing, recruitment ended), Spain (ongoing, recruitment ended), Greece (ongoing, recruitment ended), Belgium (ongoing, recruitment ended), Italy (ongoing, recruitment ended), Germany (ongoing, recruitment ended).
Therapeutic area(s): Diseases [C] - Neoplasms [C04]
Gender: Female, Male. Age: 18-64 years, 65+ years. Enrolment: 200.
Status: Ongoing, recruitment ended. Start date (EU): 2026-02-18. Decision date: 2024-11-07. Results received: No. Last updated: 2026-02-24.
Decision dates by country: DE: 2024-11-08, IT: 2024-11-13, PL: 2024-11-18, GR: 2025-01-24, ES: 2024-11-14, BE: 2024-11-08, FR: 2024-11-07

Condition(s): Non squamous non-small cell lung cancer (NSCLC)
Product: CISPLATIN, TAGRISSO 40 mg film-coated tablets, Datopotamab deruxtecan, TAGRISSO 80 mg film-coated tablets, CARBOPLATIN, PEMETREXED

Primary endpoint: PFS is defined as the time from randomization to BICR assessed progression using RECIST v1.1 or death due to any cause, regardless of whether the participant withdraws from study therapy, receives other anti cancer therapy, or clinical progression.
Endpoint(s): Overall Survival (OS) is defined as time from randomization until the date of death due to any cause. The comparison will include all randomized participants, as randomized, regardless of whether the participant withdraws from therapy or receives another anti-cancer therapy., Central Nervous System Progression-free Survival (CNS PFS) is defined as the time from randomization to BICR confirmed progression in the CNS or death due to any cause, regardless of whether the participant withdraws from study therapy, receives other anti-cancer therapy, or clinically progresses prior to BICR-confirmed CNS modified RECIST v1.1 progression., Objective Response Rate (ORR) is defined as the proportion of participants who have a confirmed complete response (CR) or confirmed partial response (PR), as determined by BICR per RECIST v1.1., Duration of Response (DoR) is defined as the time from the date of first documented response until date of documented progression per RECIST v1.1, as assessed by BICR or death due to any cause., Progression-free Survival-2 (PFS-2) is defined as the time from randomization to the earliest of the progression event (following the initial investigator assessed progression), after first subsequent therapy, or death., ORR is defined as the proportion of participants who have a confirmed CR or confirmed PR, using CNS modified RECIST v1.1., DoR is defined as the time from the date of first documented response until date of documented progression or death due to any cause using CNS modified RECIST v1.1., Time to deterioration (in pulmonary symptoms [dyspnea, cough, and chest pain]) is defined as the time from randomization until the date of deterioration. Deterioration is defined as change from baseline that reaches a meaningful change threshold., Time to deterioration in physical functioning as measured by Patient-Reported Outcomes Measurement Information System (PROMIS) Physical Function short form 8c will be evaluated. Time to deterioration (in physical functionating) is defined as the time from randomization until the date of deterioration. Deterioration is defined as change from baseline that reaches a meaningful change threshold., Time to deterioration in GHS/QoL as measured by the GHS/QoL scale from EORTC IL172 will be reported. Time to deterioration (in GHS/QoL) is defined as the time from randomization until the date of deterioration. Deterioration is defined as change from baseline that reaches a meaningful change threshold., Concentration of Dato-DXd, total anti-TROP2 antibody and DXd in plasma., Presence of antidrug antibody (ADAs) for Dato-DXd (confirmatory results: positive or negative, titers).

Source: https://euclinicaltrials.eu/ctis-public/view/2024-511362-37-00